EU clinical trial 2024-511390-30-00: Double-blind, randomised clinical study comparing efficacy and safety of Methylprednisolone Aceponate 0.1% Cream (Test) vs. Advantan(R) 0.1% Cream (Reference) vs. Vehicle in patients with mild to moderate atopic dermatitis
Protocol code: 22-01/MPA-C
Sponsor: Dermapharm AG (Pharmaceutical company). Phase: Therapeutic confirmatory (Phase III). Countries: Germany (ongoing, recruiting).
Therapeutic area(s): Diseases [C] - Skin and Connective Tissue Diseases [C17]
Gender: Female, Male. Age: 0-17 years, 18-64 years, 65+ years. Enrolment: 330.
Status: Ongoing, recruiting. Start date (EU): 2023-07-18. Decision date: 2024-05-28. Results received: No. Last updated: 2026-04-27.

Condition(s): Mild to moderate atopic dermatitis
Product: Methylprednisolone Aceponate Cream, Advantan 0.1% cream, Vehicle to Methylprednisolone Aceponate Cream

Primary endpoint: The primary endpoint of the study is the percent change from baseline (Visit 1) to Visit 4 (EoT) assessed by Eczema Area and Severity Index Score (EASI Score)
Endpoint(s): Percent change of Eczema Area and Severity Index Score (EASI Score) between baseline (Visit 1) and Visit 2 and Visit 3, Percent change of the total affected body surface area (BSA) between baseline (Visit 1) and Visit 2, Visit 3 and Visit 4, Change of the Investigator's Global Assessment (IGA) between baseline (Visit 1) and Visit 2, Visit 3 and Visit 4, Evaluation of Overall Therapeutic Success by the investigator and patient at week 3 (EOT), Patient´s assessment of severity of pruritus at visits (Visit 1, Visit 2, Visit 3 and Visit 4)

Source: https://euclinicaltrials.eu/ctis-public/view/2024-511390-30-00